EU clinical trial 2025-521259-21-00: IDENTIFICATION OF SYNOVIAL BIOMARKERS OF RESPONSE TO IXEKIZUMAB IN REFRACTORY PSORIATIC ARTHRITIS: THE PRECISE STUDY.
Protocol code: PRECISE
Sponsor: University Hospital Of Ferrara (Hospital/Clinic/Other health care facility). Phase: Therapeutic use (Phase IV). Countries: Italy (ongoing, recruiting).
Therapeutic area(s): Diseases [C] - Musculoskeletal Diseases [C05]; Diseases [C] - Immune System Diseases [C20]
Gender: Female, Male. Age: 18-64 years, 65+ years. Enrolment: 30.
Status: Ongoing, recruiting. Start date (EU): 2025-07-02. Decision date: 2025-06-24. Results received: No. Last updated: 2025-06-24.

Condition(s): PSORIATIC ARTHRITIS
Product: Taltz 80 mg solution for injection in pre-filled syringe

Primary endpoint: The primary clinical endpoint of this study is response to treatment at T12, which will be primarily measured as ACR20 response (59). The primary laboratory endpoints are the sensitivity, specificity, positive predictive values (PPV), negative predictive values (NPV) and accuracy of the test in predicting the response to the treatment [Time point: T12].
Endpoint(s): The secondary endpoints are: - Patient-level ultrasonographic response according to multi-joint PsASon22 US score (56), measured as 20% variation in the inflammatory subscore [Time point: T12]; - Joint level ultrasonographic response according to single-joint PsASon22 US score (56) [Time point: T12]; - Other key clinical endpoints (ACR50, ACR70, DAPSA, MDA, HAQ-DI score; PGA, pain, PhGA, number of swollen/tender joints, BSA) [Time points: T12, T24]; - Response to treatment according to ACR20 res

Source: https://euclinicaltrials.eu/ctis-public/view/2025-521259-21-00